EU clinical trial 2023-510365-10-00: A Study to Assess the Safety, Tolerability, Pharmacokinetics, and Pharmacodynamics of LY3938577 in Healthy Participants and Participants with Type 1 Diabetes Mellitus.
Protocol code: J4P-MC-IYAB
Sponsor: Eli Lilly & Co. (Pharmaceutical company). Phase: Human Pharmacology (Phase I)- Other. Countries: Germany (ongoing, recruiting).
Therapeutic area(s): Diseases [C] - Nutritional and Metabolic Diseases [C18]
Gender: Female, Male. Age: 18-64 years. Enrolment: 70.
Status: Ongoing, recruiting. Start date (EU): 2024-04-29. Decision date: 2024-04-23. Results received: No. Last updated: 2025-11-14.

Condition(s): Type 1 Diabetes Mellitus

Source: https://euclinicaltrials.eu/ctis-public/view/2023-510365-10-00